EU clinical trial 2024-517434-17-01: Influence of antibiotic treatment on the normal flora and the presence of resistance genes in known carriers of ESBL and VRE
Sponsor: Region Uppsala (Hospital/Clinic/Other health care facility). Phase: Therapeutic use (Phase IV). Countries: Sweden (ongoing, recruiting).
Therapeutic area(s): Diseases [C] - Bacterial Infections and Mycoses [C01]
Gender: Female, Male. Age: 18-64 years, 65+ years. Enrolment: 60.
Status: Ongoing, recruiting. Start date (EU): 2024-10-25. Decision date: 2024-10-25. Results received: No. Last updated: 2024-10-25.

Condition(s): VRE Carriage, ESBL Carriage
Product: CIPROFLOXACIN, VANCOMYCIN

Primary endpoint: 1 a) Transition from negative to positive fecal screen for VRE/EPE directly after antibiotic challenge. 1b) Differences in the microbiota's composition and diversity compared to before antibitoic challenge.
Endpoint(s): 2a) Time for participants who transitioned from negative to positive VRE/EPE carriage to transition back to negative. 2b) Time for the intestinal microbiota's composition and diversity to return to baseline. 2c) Differences regarding detection of resistance in with conventional methods compared to metagenomic methods, defined as discordant results.

Source: https://euclinicaltrials.eu/ctis-public/view/2024-517434-17-01